EU clinical trial 2023-505842-24-00: A Phase 3, Randomized, Multicenter, Double-Blind, Placebo- and Active Comparator-Controlled Study With a Randomized Withdrawal and Retreatment Period to Evaluate the Efficacy, Safety, and Tolerability of TAK-279 in Subjects With Moderate-to-Severe Plaque Psoriasis
Protocol code: TAK-279-3002
Sponsor: Takeda Development Center Americas Inc. (Pharmaceutical company). Phase: Therapeutic confirmatory (Phase III). Countries: Germany (ended), Poland (ended), Latvia (ended), Hungary (ended), Greece (ended), Spain (ended), France (ended), Czechia (ended), Bulgaria (ended).
Therapeutic area(s): Diseases [C] - Skin and Connective Tissue Diseases [C17]
Gender: Female, Male. Age: 18-64 years, 65+ years. Enrolment: 686.
Status: Ended. Start date (EU): 2024-05-07. End date (EU): 2025-10-24. End date: 2025-11-07. Decision date: 2024-02-28. Results received: No. Last updated: 2025-12-16.
Decision dates by country: DE: 2024-03-07, GR: 2024-04-12, ES: 2024-04-15, FR: 2024-02-29, BG: 2024-04-15, HU: 2024-04-15, LV: 2024-04-12, CZ: 2024-04-12, PL: 2024-03-04

Condition(s): Moderate to Severe Plaque Psoriasis
Product: Otezla 30 mg film-coated tablets, Otezla 10mg, 20mg, 30 mg film-coated tablets, TAK-279 placebo (same excipient as TAK-279), Otezla 10mg, 20mg, 30 mg film-coated tablets, Otezla 10mg, 20mg, 30 mg film-coated tablets, Apremilast placebo (same excipient as over-encapsulated Otezla), ZASOCITINIB

Primary endpoint: Static Physician's Global Assessment (sPGA) 0/1 response: Assessed as proportion of subjects achieving an sPGA of clear (0) or almost clear (1) with a ≥2-point decrease from baseline at Week 16, Psoriasis Area and Severity Index (PASI)-75 response: Assessed as proportion of subjects achieving ≥75% improvement from baseline in PASI score at Week 16.
Endpoint(s): PASI Response: Proportion of subjects achieving PASI-75 (versus apremilast), PASI-90, or PASI-100 at Week 16 or Week 24., Enhanced sPGA response: Proportion of subjects achieving an sPGA of clear (0) at Week 16, Changes in severity of psoriasis on the scalp, nail, body surface area, hands and feet using ssPGA, NAPSI, BSA, and PGA of the hands and/or feet, Time to relapse until Week 60 for PASI-75 Responders at Week 40

Source: https://euclinicaltrials.eu/ctis-public/view/2023-505842-24-00